EU clinical trial 2023-505457-40-00: A Randomized, Multi-center, Double-blind, Placebo-controlled Phase 3 Study of Bemarituzumab plus Chemotherapy versus Placebo plus Chemotherapy in Subjects with Previously Untreated Advanced Gastric or Gastroesophageal Junction Cancer with FGFR2b Overexpression FORTITUDE-101)
Protocol code: 20210096
Sponsor: Amgen Inc. (Pharmaceutical company). Phase: Therapeutic confirmatory (Phase III). Countries: Poland (ended), Hungary (ended), Latvia (ended), Denmark (ended), Estonia (ended), France (ended), Lithuania (ended), Czechia (ended), Greece (ended), Belgium (ended), Ireland (ended), Italy (ended), Romania (ended), Norway (ended), Sweden (ended), Bulgaria (ended), Spain (ended), Portugal (ended).
Therapeutic area(s): Diseases [C] - Neoplasms [C04]
Gender: Female, Male. Age: 18-64 years, 65+ years. Enrolment: 327.
Status: Ended. Start date (EU): 2022-02-02. End date (EU): 2026-04-08. End date: 2026-04-26. Decision date: 2024-02-20. Results received: No. Last updated: 2026-04-14.
Decision dates by country: NO: 2024-02-21, IE: 2024-02-20, BG: 2024-02-23, CZ: 2024-02-23, EE: 2024-02-22, GR: 2024-04-08, PL: 2024-02-29, LV: 2024-02-23, DK: 2024-02-21, SE: 2024-02-23, PT: 2024-02-21, FR: 2024-03-04, BE: 2024-03-11, IT: 2024-03-27, LT: 2024-04-02, HU: 2024-02-21, ES: 2024-02-21, RO: 2024-02-22

Condition(s): Previously Untreated Advanced Gastric or Gastroesophageal Junction Cancer with FGFR2b overexpression
Product: OXALIPLATIN, Bemarituzumab, Placebo for AMG 552, FLUOROURACIL, FOLINIC ACID

Primary endpoint: Overall survival, defined as time from randomization until death from any cause. Subjects still alive will be censored at the date last known to be alive.
Endpoint(s): Objective response, defined as best overall response (BOR) of complete response (CR) or partial response (PR) as determined by investigator per RECIST v1.1., Treatment-emergent adverse events (including all adverse events, grade ≥3, serious adverse events, fatal adverse events, and adverse events requiring permanent discontinuation of investigational product), Clinically significant changes in vital signs, visual acuity, and clinical laboratory tests, Overall survival in all randomized subjects, Progression-free survival in all randomized subjects, Objective response rate in all randomized subjects, Disease control defined as CR + PR + stable disease (SD)., Subjective score and change from baseline in following assessments:, European Organization for the Research and Treatment of Cancer Quality of Life Questionnaire (QLQ-C30) individual scores (raw and transformed) for the 5 functional scales, 9 symptom scales, global health status/quality of life scale, and change from baseline at each assessment, Stomach cancer related symptoms measured by European Organisation for Research and Treatment of Cancer Quality of Life Questionnaire – Stomach (EORTC-QLQ-STO22), Summary scores at each assessment and changes from baseline of visual analogue scale (VAS) as measured by the EuroQol 5-dimensional (EQ-5D-5L), Time to deterioration in stomach-cancer related symptoms scores, Time to deterioration in HRQoL scores, Time to deterioration in physical function scores, PK parameters for bemarituzumab, including maximum observed concentration (Cmax) and observed concentration at the end of a dose interval (Ctrough), Anti-bemarituzumab antibody formation, DOR is defined as the time from the first documentation of OR (by investigator per RECIST v1.1) until the first documentation of disease progression or death due to any cause, whichever occurs first. Only subjects who have achieved OR will be evaluated for DOR. DOR will be censored at the last evaluable postbaseline tumor assessment prior to subsequent anticancer therapy; otherwise, at date of first documentation of objecvtive response., PFS, defined as the time from randomization until the first documentation of radiologic disease progression or death due to any cause, whichever occurs first in the absence of subsequent anticancer therapy. PFS will be censored at the last evaluable post-baseline tumor assessment prior to subsequent anticancer therapy; otherwise, at randomization. Progression will be based on assessment by investigator per RECIST v1.1.

Source: https://euclinicaltrials.eu/ctis-public/view/2023-505457-40-00